EU clinical trial 2024-519246-75-01: An Open-label, Single-arm, Global Study of Perioperative Durvalumab With Cisplatin-based Neoadjuvant Chemotherapy in Patients With Muscle-Invasive Bladder Cancer (NIAGARA-2)
Protocol code: D933RC00002
Sponsor: AstraZeneca AB (Pharmaceutical company). Phase: Therapeutic exploratory (Phase II). Countries: Italy (authorised, recruiting), Spain (ongoing, recruiting), France (ongoing, recruiting), Netherlands (authorised, recruitment pending).
Therapeutic area(s): Diseases [C] - Neoplasms [C04]
Gender: Female, Male. Age: 18-64 years, 65+ years. Enrolment: 60.
Start date (EU): 2026-06-15. Decision date: 2026-05-19. Results received: No. Last updated: 2026-05-22.
Decision dates by country: FR: 2026-05-19, IT: 2026-05-21, NL: 2026-05-19, ES: 2026-05-22

Condition(s): Patients With Muscle-Invasive Bladder Cancer
Product: IMFINZI 50 mg/mL concentrate for solution for infusion.

Primary endpoint: Incidence of Grade 3 or 4 PRAEs as observed prior to RC. A PRAE is defined as an AE that has been assessed by the investigator to be possibly related to study treatment.
Endpoint(s): Incidence, severity, nature, seriousness, intervention/treatment, outcome, and causality of treatment-emergent AEs, including PRAEs, AESIs, imAEs, AEs, and SAEs; AEs resulting in study treatment interruption and discontinuation; laboratory findings., EFS is defined as the time from first neoadjuvant durvalumab + ddMVAC treatment until the earliest occurrence of any of the following events: • First recurrence of disease after RC • First documented progression in participants who were medically precluded from RC • Time of expected surgery in participants who refuse to undergo RC or failure to undergo RC in participants with residual disease, DFS is defined as the time from the date of RC to the earliest of the first recurrence of disease post RC or death due to any cause. The primary measures of interest are DFS rates at 18 and 24 months., OS is defined as the time from first neoadjuvant durvalumab + ddMVAC until death due to any cause. The primary measure of interest is OS rate at 12 months., pCR rate is defined as the proportion of participants whose pathologic staging is T0N0M0 as assessed per local pathology review using specimens obtained via RC. Participants who do not undergo RC will be included as failures (did not achieve T0N0M0)., pDS rate is defined as the proportion of participants whose pathologic staging is < P2 per local pathology review using specimens obtained via RC.

Source: https://euclinicaltrials.eu/ctis-public/view/2024-519246-75-01